EU clinical trial 2023-504310-30-00: A Phase 1, Randomized, Double-Blind, Placebo and Positive-Controlled Crossover Study to Evaluate the Effect of Clinical and Supraclinical Doses of GEH200486 0.5 M Injection on the Thorough QT/QTc in Healthy Volunteers.
Protocol code: GE-227-002
Sponsor: GE Healthcare Limited (Pharmaceutical company). Phase: Human Pharmacology (Phase I)- Other. Countries: Netherlands (ended).
Therapeutic area(s): Analytical, Diagnostic and Therapeutic Techniques and Equipment [E] - Diagnosis [E01]
Gender: Female, Male. Age: 18-64 years. Enrolment: 72.
Status: Ended. Start date (EU): 2023-08-16. End date (EU): 2025-03-25. Decision date: 2023-07-31. Results received: No. Last updated: 2024-12-12.

Condition(s): Healthy volunteers

Source: https://euclinicaltrials.eu/ctis-public/view/2023-504310-30-00